EU clinical trial 2023-504865-21-00: A Phase 3, Randomized, Open-label, Active-Comparator-Controlled Clinical Study to Evaluate the Safety and Efficacy of Bomedemstat (MK-3543/IMG-7289) versus Best Available Therapy (BAT) in Participants With Essential Thrombocythemia who have an Inadequate Response to or are Intolerant of Hydroxyurea
Protocol code: MK-3543-006
Sponsor: Merck Sharp & Dohme LLC (Pharmaceutical company). Phase: Therapeutic confirmatory (Phase III). Countries: Spain (ongoing, recruitment ended), France (ongoing, recruitment ended), Germany (ongoing, recruitment ended), Netherlands (ongoing, recruitment ended), Sweden (ongoing, recruitment ended), Poland (ongoing, recruitment ended), Belgium (ongoing, recruitment ended), Hungary (ongoing, recruitment ended), Italy (ongoing, recruitment ended), Portugal (ongoing, recruitment ended).
Therapeutic area(s): Diseases [C] - Cardiovascular Diseases [C14]
Gender: Female, Male. Age: 18-64 years, 65+ years. Enrolment: 155.
Status: Ongoing, recruitment ended. Start date (EU): 2024-04-15. Decision date: 2024-03-26. Results received: No. Last updated: 2026-07-14.
Decision dates by country: IT: 2024-03-27, NL: 2024-04-02, DE: 2024-03-27, SE: 2024-03-27, HU: 2024-03-26, PL: 2024-04-02, PT: 2024-05-09, ES: 2024-04-01, BE: 2024-03-28, FR: 2024-03-28

Condition(s): Essential Thrombocythemia patients who have an inadequate response to or are intolerant of hydroxyurea
Product: MK-3543, MK-3543, PEGINTERFERON ALFA-2A, RUXOLITINIB, MK-3543, BUSULFAN, ANAGRELIDE HYDROCHLORIDE MONOHYDRATE, RUXOLITINIB, MK-3543, PEGINTERFERON ALFA-2A

Primary endpoint: Durable Clinicohematologic Response (DCHR) Rate
Endpoint(s): Change from Baseline in Myelofibrosis Symptom Assessment Form (MFSAF) v4.0 Individual Fatigue Symptom Item Score, Change from Baseline in Patient-reported Outcomes Measurement Information System (PROMIS) Fatigue SF-7a Total Fatigue Score, Change from Baseline in Total Symptom Score as Measured on the MFSAF v4.0, Duration of Clinicohematologic Response (DOCHR), Duration of Hematologic Remission (DOHR), Percentage of Participants with Thrombotic Events, Percentage of Participants with Major Hemorrhagic Events, Disease Progression Rate, Number of Participants with An Adverse Event (AE), Number of Participants Discontinuing from Study Therapy Due to an AE

Source: https://euclinicaltrials.eu/ctis-public/view/2023-504865-21-00